EU clinical trial 2023-508149-42-00: An exploratory study to investigate the effect of FE 999302 when given during different time periods to women undergoing controlled ovarian stimulation with follitropin delta
Protocol code: 000427
Sponsor: Ferring Pharmaceuticals A/S (Pharmaceutical company). Phase: Human Pharmacology (Phase I)- Other. Countries: Denmark (ended), Czechia (ended), Spain (ended), Belgium (ended), Norway (ended).
Therapeutic area(s): Diseases [C] - Female Urogenital Diseases and Pregnancy Complications [C13]
Gender: Female. Age: 18-64 years. Enrolment: 201.
Status: Ended. Start date (EU): 2024-07-16. End date (EU): 2025-09-05. Decision date: 2024-06-17. Results received: No. Last updated: 2025-07-04.
Decision dates by country: DK: 2024-06-17, ES: 2024-06-19, BE: 2024-09-02, CZ: 2024-09-03, NO: 2024-06-19

Condition(s): Infertility in women undergoing assisted reproductive technologies (ART)

Source: https://euclinicaltrials.eu/ctis-public/view/2023-508149-42-00